EU clinical trial 2023-509312-29-00: Tolerance study of allogeneic of Adipose tissue derived mesenchymal Stroma/stem Cells (AdMSC) transplantation in patients with critical limb ischemia
Protocol code: RC31/21/0168
Sponsor: Centre Hospitalier Universitaire De Toulouse (Hospital/Clinic/Other health care facility). Phase: Human Pharmacology (Phase I)- First administration to humans. Countries: France (ongoing, recruiting).
Therapeutic area(s): Diseases [C] - Cardiovascular Diseases [C14]
Gender: Female, Male. Age: 18-64 years, 65+ years. Enrolment: 10.
Status: Ongoing, recruiting. Start date (EU): 2026-02-11. Decision date: 2024-10-07. Results received: No. Last updated: 2025-12-04.

Condition(s): critical limb ischemia

Source: https://euclinicaltrials.eu/ctis-public/view/2023-509312-29-00